EU clinical trial 2022-502752-31-00: Open-label Phase 3 Study of MK-7684A (Coformulation of Vibostolimab with Pembrolizumab) in Combination with Concurrent Chemoradiotherapy followed by MK7684A Versus Concurrent Chemoradiotherapy followed by Durvalumab in Participants with Unresectable, Locally Advanced, Stage III NSCLC (KEYVIBE-006)
Protocol code: MK-7684A-006
Sponsor: Merck Sharp & Dohme LLC (Pharmaceutical company). Phase: Phase III and phase IV (Integrated). Countries: Spain (ended), Italy (ended), Germany (ended), Romania (ended), Portugal (ended), Greece (ended), Austria (ended), Croatia (ended), Czechia (ended), France (ended), Poland (ended).
Therapeutic area(s): Diseases [C] - Neoplasms [C04]
Gender: Female, Male. Age: 18-64 years, 65+ years. Enrolment: 68.
Status: Ended. Start date (EU): 2022-04-29. End date (EU): 2026-05-06. End date: 2026-06-15. Decision date: 2023-09-11. Results received: No. Last updated: 2026-06-17.
Decision dates by country: AT: 2024-10-07, HR: 2024-10-03, FR: 2024-09-30, PL: 2024-10-07, ES: 2023-09-11, GR: 2023-10-13, IT: 2023-09-13, RO: 2023-09-18, DE: 2023-09-26, CZ: 2024-10-02, PT: 2023-10-11

Condition(s): Non-small cell lung cancer
Product: PEMETREXED, PACLITAXEL, CARBOPLATIN, DURVALUMAB, Eto-GRY® 20 mg/ml Konzentrat zur Herstellung einer Infusionslösung, MK-7684A, CISPLATIN, ALIMTA 500 mg powder for concentrate for solution for infusion, IMFINZI 50 mg/mL concentrate for solution for infusion., ETOPOSIDE

Primary endpoint: Per protocol amendment 4, there are no primary or secondary endpoints

Source: https://euclinicaltrials.eu/ctis-public/view/2022-502752-31-00